EU clinical trial 2023-504817-56-00: Safe, effective and cost-effective oxygen saturation targets for children and adolescents with respiratory distress: a randomized controlled trial.
Protocol code: 2022.0100
Sponsor: Spaarne Gasthuis (Hospital/Clinic/Other health care facility). Phase: Therapeutic use (Phase IV). Countries: Netherlands (ended).
Therapeutic area(s): Diseases [C] - Respiratory Tract Diseases [C08]
Gender: Female, Male. Age: 0-17 years. Enrolment: 560.
Status: Ended. Start date (EU): 2023-09-05. End date (EU): 2025-03-04. Decision date: 2023-06-27. Results received: No. Last updated: 2024-05-28.

Condition(s): Bronchiolitis, Viral wheeze / bronchial hyperreactivity, Lower respiratory tract infection
Product: Conoxia Liquid, 100% v/v, medicinaal gas, vloeibaar gemaakt.

Primary endpoint: the time from admission to meeting all discharge criteria
Endpoint(s): Length of stay, Number of PICU admissions, Time spent on oxygen therapy, Duration of symptoms, Time from admission to return to normal health, Time from admission to return to school/day care, Unscheduled health care visits after discharge during follow-up, Patient Quality of Life, Parental anxiety, Overall pediatric health, Economic evaluation, Reasons for starting oxygen therapy

Source: https://euclinicaltrials.eu/ctis-public/view/2023-504817-56-00